EU clinical trial 2023-505172-29-00: A Phase 2 Peri-Operative Trial of Fianlimab and Cemiplimab in Combination With Chemotherapy Versus Cemiplimab in Combination With Chemotherapy in Patients With Resectable Early Stage (Stage II to IIIB [N2]) NSCLC
Protocol code: R3767-ONC-2266
Sponsor: Regeneron Pharmaceuticals Inc. (Pharmaceutical company). Phase: Therapeutic exploratory (Phase II). Countries: Germany (ongoing, recruitment ended), France (ongoing, recruitment ended), Italy (ongoing, recruitment ended), Spain (ongoing, recruitment ended), Romania (ended).
Therapeutic area(s): Diseases [C] - Neoplasms [C04]
Gender: Female, Male. Age: 18-64 years, 65+ years. Enrolment: 103.
Start date (EU): 2025-04-24. Decision date: 2024-11-06. Results received: No. Last updated: 2026-04-15.
Decision dates by country: RO: 2024-11-11, ES: 2024-11-06, FR: 2024-11-07, IT: 2024-11-14, DE: 2024-11-08

Condition(s): Resectable Non-small Cell Lung Cancer
Product: Cemiplimab and Fianlimab - 1, Placebo, LIBTAYO 350 mg concentrate for solution for infusion., PEMETREXED, CARBOPLATIN, CISPLATIN, Cemiplimab & Fianlimab - 2, PACLITAXEL

Primary endpoint: Pathological complete response (pCR) as evaluated by blinded independent pathological review (BIPR) in post-treatment resected tumor samples
Endpoint(s): Event-Free Survival (EFS), Major pathological response (MPR) by BIPR in post-treatment resected tumor samples, MPR by local pathology review in post-treatment resected tumor samples, Tumor response to neoadjuvant therapy per Response Evaluation Criteria in Solid Tumors version 1.1 (RECIST 1.1) criteria by investigator assessment, Occurrence of Adverse events (AEs), Occurrence of Treatment-emergent adverse event (TEAEs), Occurrence of Serious adverse events (SAEs), Occurrence of Adverse events of special interest (AESIs), Occurrence of immune-mediated adverse events (imAEs), Occurrence of interruption and discontinuation of study drug(s) due to TEAE, Occurrence of laboratory abnormalities - Grade ≥3 per National Cancer Institute-Common Terminology Criteria for Adverse Events (NCI-CTCAE v5.0) including standard hematology, chemistry, urinalysis, and other lab tests, Occurrence of death due to TEAE, Concentrations of cemiplimab in serum, Concentrations of fianlimab in serum, Anti-drug antibodies (ADA) to fianlimab in serum over time, ADA to cemiplimab in serum over time, Percentage of patients with definitive surgery, Percentage of patients with cancelled surgery, Percentage of patients with delayed surgery, Completeness of resection (R0, R1, R2, Rx), Length in delay of surgery, Type of surgery (lobectomy, sleeve lobectomy, bilobectomy, pneumonectomy, other), Median length of hospital stay, Surgical approach (thoracotomy, minimally invasive, minimally invasive to thoracotomy), Incidence of peri operative AE associated with surgery, Incidence of peri operative SAE associated with surgery, Incidence of post operative AE associated with surgery, Incidence of post operative SAE associated with surgery, Overall change in patient-reported global health status/QoL per European Organization for Research and Treatment of Cancer Quality of Life Questionnaire Core 30 (EORTC QLQ-C30), Overall change in patient-reported physical functioning per EORTC QLQ-C30, Overall change in patient-reported role functioning per EORTC QLQ-C30, Overall change in patient-reported chest pain per European Organization for Research and Treatment of Cancer Quality of Life Questionnaire Lung Cancer 13 (EORTC QLQ-LC13), Overall change in patient-reported dyspnea per EORTC QLQ-LC13, Overall change in patient-reported cough per EORTC QLQ-LC13, Overall change in patient-reported composite of chest pain, dyspnea, and cough per EORTC QLQ-LC13, Change in patient-reported general health status per EuroQoL 5-Dimensional 5-Level Scale (EQ-5D-5L) index, Change in patient-reported general health status per Visual analogue scale (VAS) scores, Time until definitive deterioration in patient-reported global health status/QoL per EORTC QLQ-C30, Time until definitive deterioration in patient-reported physical functioning per EORTC QLQ-C30, Time until definitive deterioration in patient-reported role functioning per EORTC QLQ-C30, Time until definitive deterioration in patient-reported chest pain per EORTC QLQ-LC13, Time until definitive deterioration in patient-reported dyspnea per EORTC QLQ-LC13, Time until definitive deterioration in patient-reported cough per EORTC QLQ-LC13, Time until definitive deterioration in patient-reported composite of chest pain, dyspnea and cough per EORTC QLQ-LC13

Source: https://euclinicaltrials.eu/ctis-public/view/2023-505172-29-00